EU clinical trial 2024-513683-25-00: Randomized, controlled, multi-center phase II clinical trial for the treatment of patellofemoral osteoarthritis with nasal chondrocyte-based tissue engineered cartilage implantation vs current standard of care (ENCANTO)
Sponsor: Universitaetsspital Basel (Hospital/Clinic/Other health care facility). Phase: Therapeutic exploratory (Phase II). Countries: Sweden (ongoing, recruiting), Germany (authorised, recruiting), Netherlands (authorised, recruitment pending), Italy (ongoing, recruiting), Poland (ongoing, recruiting), Austria (ongoing, recruiting), Croatia (authorised, recruiting).
Therapeutic area(s): Diseases [C] - Musculoskeletal Diseases [C05]
Gender: Female, Male. Age: 18-64 years, 65+ years. Enrolment: 122.
Start date (EU): 2025-06-30. Decision date: 2025-06-10. Results received: No. Last updated: 2025-06-17.
Decision dates by country: AT: 2025-06-11, HR: 2025-06-13, IT: 2025-06-13, SE: 2025-06-10, PL: 2025-06-16, DE: 2025-06-13, NL: 2025-06-16

Condition(s): Patellofemoral osteoarthritis
Product: N-TEC

Primary endpoint: Change in KOOS-5 subjective score from baseline to the 24-month follow-up
Endpoint(s): Mean KOOS subscores at all timepoints (baseline, 6, 12 and 24 months), Kujala Anterior Knee Pain Scale at 6, 12 and 24 months, WOMAC Score at baseline, 6, 12 and 24 months, EQ-5D-5L at baseline 6, 12 and 24 months, GROC likert scale at baseline, 6, 12 and 24 months, Marx Activity Rating Scale at baseline, 6, 12 and 24 months, VAS Score at baseline, 6, 12 and 24 months, Patient Satisfaction Questionnaire at 24 months, MRI at baseline, 6, 12 and 24 months, X-ray at baseline, 6, 12 and 24 months, Safety (number of SARs and SUSARs), Number of treatment failures at 24 months

Source: https://euclinicaltrials.eu/ctis-public/view/2024-513683-25-00